EU clinical trial 2024-512905-18-00: Clinical research trial for evaluating different properties, such as safety, tolerability and body interaction, of a new drug called ALY688ER, administered as subcutaneous injection in healthy overweight or obese people.
Protocol code: ALY688ER-101
Sponsor: Allysta Pharmaceuticals Inc. (Pharmaceutical company). Phase: Human Pharmacology (Phase I)- First administration to humans. Countries: Bulgaria (authorised, recruitment pending).
Therapeutic area(s): Diseases [C] - Nutritional and Metabolic Diseases [C18]
Gender: Female, Male. Age: 18-64 years, 65+ years. Enrolment: 56.
Status: Authorised, recruitment pending. Decision date: 2025-10-10. Results received: No. Last updated: 2025-10-10.

Condition(s): NASH

Source: https://euclinicaltrials.eu/ctis-public/view/2024-512905-18-00